EU clinical trial 2024-516652-18-00: A Phase 3 Randomized, Double-blind, Placebo-controlled Study to Evaluate the Impactof Maridebart Cafraglutide on Cardiovascular Outcomes in Participants with Atherosclerotic Cardiovascular Disease and Overweight or Obesity (MARITIME-CV)
Protocol code: 20220196
Sponsor: Amgen Inc. (Pharmaceutical company). Phase: Therapeutic confirmatory (Phase III). Countries: Slovakia (ongoing, recruiting), Denmark (ongoing, recruiting), Portugal (ongoing, recruiting), Czechia (ongoing, recruiting), Poland (ongoing, recruiting), Greece (ongoing, recruiting), Bulgaria (ongoing, recruiting), France (ongoing, recruiting), Spain (ongoing, recruiting), Sweden (ongoing, recruiting), Finland (ongoing, recruiting), Belgium (ongoing, recruiting), Romania (ongoing, recruiting), Germany (ongoing, recruiting), Hungary (ongoing, recruiting), Netherlands (ongoing, recruiting), Italy (ongoing, recruiting), Austria (ongoing, recruiting).
Therapeutic area(s): Diseases [C] - Cardiovascular Diseases [C14]
Gender: Female, Male. Age: 18-64 years. Enrolment: 6002.
Status: Ongoing, recruiting. Start date (EU): 2025-10-10. Decision date: 2025-10-06. Results received: No. Last updated: 2026-06-08.
Decision dates by country: FR: 2025-10-08, RO: 2025-10-09, SE: 2025-10-06, HU: 2025-10-07, BG: 2025-10-10, NL: 2025-10-07, DE: 2025-10-09, IT: 2025-10-06, PT: 2025-10-06, AT: 2025-10-10, FI: 2025-10-10, DK: 2025-10-06, GR: 2025-10-08, PL: 2025-10-08, BE: 2025-10-06, ES: 2025-10-09, CZ: 2025-10-07, SK: 2025-10-06

Condition(s): Atherosclerotic cardiovascular disease (ASCVD) and obesity or overweight
Product: AMG 133, AMG 133, AMG 133, Placebo for Maridebart cafraglutide, AMG 133

Primary endpoint: Time to first occurrence of a composite endpoint consisting of: CV death, myocardial infarction (MI), or ischemic stroke (3-point major adverse cardiac events [3-P MACE]), Time to first occurrence of a composite endpoint consisting of: all-cause death, MI, ischemic stroke, coronary revascularization, or heart failure (HF) event (5-point major adverse cardiac events [5-P MACE])
Endpoint(s): Time to first occurrence of a composite endpoint consisting of: CV death, MI, ischemic stroke, or HF event, Time to first occurrence of a composite endpoint consisting of: CV death, MI, ischemic stroke or coronary revascularization

Source: https://euclinicaltrials.eu/ctis-public/view/2024-516652-18-00